EU clinical trial 2023-506705-20-00: CARMOD - Golcadomide (BMS-986369) post-CAR T-cell in R/R Aggressive large B-cell lymphoma patients with high risk of relapse
Protocol code: Carmod
Sponsor: Lymphoma Academic Research Organisation (Laboratory/Research/Testing facility). Phase: Therapeutic exploratory (Phase II). Countries: France (ongoing, recruiting).
Therapeutic area(s): Diseases [C] - Hemic and Lymphatic Diseases [C15]
Gender: Female, Male. Age: 18-64 years, 65+ years. Enrolment: 61.
Status: Ongoing, recruiting. Start date (EU): 2024-06-14. Decision date: 2024-04-05. Results received: No. Last updated: 2026-04-20.

Condition(s): relapsed or refractory patients with aggressive large B-cell lymphoma at high risk of relapse
Product: Breyanzi 1.1-70 × 106 cells/mL / 1.1-70 × 106 cells/mL dispersion for infusion, Kymriah 1.2 x 10^6 – 6 x 10^8 cells dispersion for infusion, YESCARTA 0.4 – 2 x 10e8 cells dispersion for infusion, Golcadomide

Primary endpoint: Efficacy determination will be based upon the primary endpoint of complete metabolic response (CMR) rate at 3 months after infusion of anti-CD19 CAR T-cell assessed by study investigator.
Endpoint(s): Objective response rate (ORR), Complete metabolic response (CMR), Partial metabolic response (PMR), Duration of response (DoR), Event-free survival (EFS), Progression-free survival (PFS), Time to next anti-lymphoma therapy (TTNLT), Overall survival (OS)

Source: https://euclinicaltrials.eu/ctis-public/view/2023-506705-20-00